EU clinical trial 2025-521711-39-00: A 52-Week, Phase 3, Open-Label Extension Study of ACP-204 in Adults With Lewy Body Dementia Psychosis (LBDP)
Protocol code: ACP-204-013
Sponsor: Acadia Pharmaceuticals Inc. (Pharmaceutical company). Phase: Therapeutic confirmatory (Phase III). Countries: Czechia (ongoing, recruiting), Italy (ongoing, recruiting), France (authorised, recruitment pending), Bulgaria (ongoing, recruiting).
Therapeutic area(s): Diseases [C] - Nervous System Diseases [C10]
Gender: Female, Male. Age: 18-64 years, 65+ years. Enrolment: 49.
Start date (EU): 2026-05-17. Decision date: 2025-11-03. Results received: No. Last updated: 2026-07-22.
Decision dates by country: FR: 2025-11-10, CZ: 2025-11-03, BG: 2025-11-05, IT: 2025-11-07

Condition(s): Lewy body Dementia psychosis (LBDP)

Primary endpoint: Treatment-emergent adverse events (TEAEs)

Source: https://euclinicaltrials.eu/ctis-public/view/2025-521711-39-00